EU clinical trial 2024-517178-48-00: Randomized, double-blind, placebo-controlled study evaluating the efficacy and safety of nandrolone decanoate therapy and therapy with complex physiotherapy and diet in the treatment of sarcopenia
Protocol code: NIGRIR_002SARKOPENIA
Sponsor: Narodowy Instytut Geriatrii Reumatologii I Rehabilitacji Im Prof. Dr Hab. Med. Eleonory Reicher (Hospital/Clinic/Other health care facility). Phase: Therapeutic exploratory (Phase II). Countries: Poland (ongoing, recruiting).
Therapeutic area(s): Diseases [C] - Musculoskeletal Diseases [C05]
Gender: Female, Male. Age: 18-64 years, 65+ years. Enrolment: 168.
Status: Ongoing, recruiting. Start date (EU): 2023-03-15. Decision date: 2024-10-31. Results received: No. Last updated: 2024-10-31.

Condition(s): Sarcopenia is characterized by loss of the muscle mass and function. It develops with age and is associated with a high risk of functional loss in complex activities of daily living, deterioration and quality of life, falls and injuries, patient institutionalization, hospitalization, and mortality in older adults.
Product: Injectio Natrii Chlorati Isotonica Polpharma, 9 mg/ml, rozpuszczalnik do sporządzania leków parenteralnych, Deca-Durabolin, 50 mg/ml, roztwór do wstrzykiwań

Primary endpoint: Change in physical fitness as assessed by the SPPB test score (4- meter gait speed test version) in points, at the 5th study visit relative to the test score performed at visit 1, Change in the 400-meter walk test score in time units, at the 5th test visit, relative to the test score taken at visit 1

Source: https://euclinicaltrials.eu/ctis-public/view/2024-517178-48-00